EU clinical trial 2024-510899-20-00: MK-4646 Single Ascending Dose Study and DDI in Healthy Participants
Protocol code: MK-4646-001
Sponsor: Merck Sharp & Dohme LLC (Pharmaceutical company). Phase: Human Pharmacology (Phase I)- First administration to humans. Countries: Belgium (ended).
Therapeutic area(s): Diseases [C] - Virus Diseases [C02]
Gender: Male. Age: 18-64 years. Enrolment: 28.
Status: Ended. Start date (EU): 2024-06-19. End date (EU): 2024-11-14. End date: 2024-11-15. Decision date: 2024-06-17. Results received: No. Last updated: 2024-06-17.

Condition(s): HIV infection

Source: https://euclinicaltrials.eu/ctis-public/view/2024-510899-20-00